EU clinical trial 2023-509320-17-00: A multicenter study of secukinumab, with a randomized double-blind, placebo-controlled withdrawal-retreatment period, to evaluate maintenance of response in participants with non-radiographic axial spondyloarthritis who achieved remission
Protocol code: CAIN457I2401
Sponsor: Novartis Pharma AG (Pharmaceutical company). Phase: Therapeutic use (Phase IV). Countries: Belgium (ongoing, recruitment ended), Poland (ongoing, recruitment ended), Hungary (ongoing, recruitment ended), France (ongoing, recruitment ended), Italy (ongoing, recruitment ended), Romania (ongoing, recruitment ended), Germany (ongoing, recruitment ended), Netherlands (ended), Czechia (ongoing, recruitment ended).
Therapeutic area(s): Diseases [C] - Immune System Diseases [C20]
Gender: Female, Male. Age: 18-64 years, 65+ years. Enrolment: 244.
Start date (EU): 2023-03-28. Decision date: 2024-05-17. Results received: No. Last updated: 2025-12-10.
Decision dates by country: BE: 2024-05-21, CZ: 2024-05-21, FR: 2024-05-22, DE: 2024-05-21, HU: 2024-05-21, IT: 2024-05-22, RO: 2024-05-20, NL: 2024-05-21, PL: 2024-05-17

Condition(s): non-radiographic axial spondyloarthritis
Product: Placebo to AIN457 150 mg/1 mL Solution for injection in pre-filled syringe, SECUKINUMAB

Primary endpoint: The proportion of participants remaining flare-free at Week 120
Endpoint(s): Time to flare during Treatment Period 2, Safety and tolerability demonstrated by assessing: • Adverse events (AEs) and serious adverse events (SAEs) (incidence, severity, and relationship with study drug) • Clinically significant changes in laboratory parameters and vital signs

Source: https://euclinicaltrials.eu/ctis-public/view/2023-509320-17-00